EU clinical trial 2024-515018-42-00: AMIND - AMIloride for the treatment of Nephrogenic Diabetes insipidus for patients with bipolar disorder treated with lithium: a randomized controlled trial
Protocol code: APHP200042
Sponsor: Assistance Publique Hopitaux De Paris (Hospital/Clinic/Other health care facility). Phase: Therapeutic exploratory (Phase II). Countries: France (ended).
Therapeutic area(s): Psychiatry and Psychology [F] - Mental Disorders [F03]
Gender: Female, Male. Age: 18-64 years, 65+ years. Enrolment: 148.
Status: Ended. Start date (EU): 2023-01-11. End date (EU): 2026-01-05. Decision date: 2024-08-09. Results received: No. Last updated: 2024-08-09.

Condition(s): Patients treated with lithium carbonate for a bipolar disorder treated for at least 5 years and with a urine concentration defect.
Product: Placebo d'amiloride, AMILORIDE, AMILORIDE

Primary endpoint: The primary endpoint is the percentage change in maximal urine osmolality before and after the 2 months treatment period
Endpoint(s): Percentage change in maximal urine osmolality between baseline (before treatment) and at 6 and 12 months., Self-declared mean number of nocturnal voids before treatment and at 2, 6 and 12 months., Thirst intensity and distress scales score before treatment and at 2, 6 and 12 months., Presence of polyuria (defined as a daily urine output > 3 L/day) after 2, 6, 12 months of treatment, Quality-of-life scale score (SF36) before treatment and at 2, 6 and 12 months., eGFR (estimated by the CKD-EPI equation based on standardized serum creatinine measurement) before treatment and at 2, 6 and 12 months., Mood Scale scores (YMRS and MADRS), anxiety scale score (GAD7) and the Pittsburgh sleep score (PSQI) before treatment and at 2, 6 and 12 months, Total number of hospital admission for maniac or depressive relapse during 12 months of treatment, Difference in residual plasma lithium levels before and after the 2 months treatment period, Short- and long-term tolerances evaluated via Common Terminology Criteria for Adverse Events (CTCAE) with an unacceptable toxicity defined as a grade >= 3 at 2, 6 and 12 months.

Source: https://euclinicaltrials.eu/ctis-public/view/2024-515018-42-00